EU clinical trial 2023-505832-36-01: OPEN-LABEL EXTENSION STUDY TO ASSESS THE SAFETY AND LONG-TERM EFFECTIVENESS OF ORALLY ADMINISTERED EFAVIRENZ IN PATIENTS DIAGNOSED WITH ADULT OR LATE-ONSET JUVENILE TYPE C NIEMANN-PICK DISEASE WITH COGNITIVE IMPAIRMENT
Protocol code: HUB-NEU-2023-01
Sponsor: Bellvitge University Hospital, Fundacio Institut D'Investigacio Biomedica De Bellvitge IDIBELL (Hospital/Clinic/Other health care facility, Laboratory/Research/Testing facility). Phase: Therapeutic exploratory (Phase II). Countries: Spain (ended).
Therapeutic area(s): Diseases [C] - Congenital, Hereditary, and Neonatal Diseases and Abnormalities [C16]; Diseases [C] - Nervous System Diseases [C10]
Gender: Female, Male. Age: 18-64 years. Enrolment: 16.
Status: Ended. Start date (EU): 2024-11-07. End date (EU): 2026-01-28. Decision date: 2024-05-16. Results received: No. Last updated: 2025-08-26.

Condition(s): Type C Niemann-Pick Disease
Product: EFAVIRENZ

Primary endpoint: Number of adverse events (AEs) according to seriousness, severity, and relationship with EFV, Changes in the liver function panel, Change (not deterioration) in cognitive performance at 52 weeks of starting treatment with EFV, assessed by: (1) CDR-SoB score; (2) FCSRT score (verbal memory); and (3) executive functions - a-BT scores (digit span and mental control subtests), verbal fluency, TMT A and B scores, and SCWT scores.
Endpoint(s): Changes at 52 weeks of starting treatment with EFV relative to baseline in: (1) SARA score; (2) EAT-10 score; and (3) PDS score, Weighted CDR-SoB score, Weighted FCSRT score, Weighted a-BT, Weighted Verbal lfuency score, Weighted TMT A and B score, Weighted SCWT score, Weighted WAIS III/WAIS IV score, Weighted BNT, Naming and Semantic Knowledge subtests’ scores, Weighted JLO score, Weighted DEX score, Weighted NPI score, Weighted NPI score, Weighted AES score, Weighted BDI score, Weighted C-SSRS score, Brain 18FDG PET–Scan: Quantification of cerebellar, cortical, and thalamic metabolism, Brain MRI: Cortical, white matter, basal ganglia, and cerebellar structures volumetric analysis, Abdominal ultrasound: Spleen size (cm)., Oculography: initial speed, amplitude, and execution speed of vertical and horizontal saccades, Plasma Oxysterols levels, Plasma Lyso-SM-509 level, Plasma 24-OH-Cholesterol level, Cerebrospinal Fluid (CSF) Beta-Amyloid, Tau, and phosphorylated Tau levels

Source: https://euclinicaltrials.eu/ctis-public/view/2023-505832-36-01